EU clinical trial 2023-508827-10-00: Neoadjuvant and adjuvant RIBOciclib and endocrine therapy for cLinicAlly high-RISk estrogen receptor-positive (ER+) and HER2-negative (HER2-) breast cancer (RIBOLARIS)
Protocol code: SOLTI-1911
Sponsor: Solti Group (Pharmaceutical company). Phase: Therapeutic exploratory (Phase II). Countries: France (ongoing, recruitment ended), Spain (ongoing, recruitment ended).
Therapeutic area(s): Diseases [C] - Neoplasms [C04]
Gender: Female, Male. Age: 18-64 years. Enrolment: 1100.
Status: Ongoing, recruitment ended. Start date (EU): 2025-10-13. Decision date: 2024-11-11. Results received: No. Last updated: 2026-07-16.
Decision dates by country: ES: 2024-12-13, FR: 2024-11-20

Condition(s): Patients with primary operable stage II, grade 2 or 3, Ki67 #20%, HR+/HER2breast cancer to evaluate safety and long-term efficacy of a non-chemo treatment in patients biologically responders to neoadjuvant ribociclib and letrozole., Patients with primary operable stage II, grade 2 or 3, Ki67 #20%, HR+/HER2breast cancer to evaluate safety and long-term efficacy of a non-chemo treatment in patients biologically responders to neoadjuvant ribociclib and letrozole.
Product: FEMARA 2,5 mg, comprimé pelliculé, Kisqali 200 mg film-coated tablets

Primary endpoint: Distant metastasis-free survival (DMFS) DMFS is defined as the time from date of surgery to date of first event of distant metastatic recurrence or death (any cause).
Endpoint(s): Invasive disease-free survival (IDFS) iDFS is defined as the time from surgery until the date of the first occurrence of one of the following events: recurrence of ipsilateral invasive breast tumor, recurrence of ipsilateral locoregional invasive disease, a distant disease recurrence, contralateral invasive breast cancer, second primary or death from any cause., pCR in the breast and axillary lymph nodes (pCRBL) after completion of study treatment, defined as the complete absence of invasive carcinoma in the breast and axillary lymph nodes on histological examination at the time of definitive surgery, irrespective of in situ carcinoma in the breast., Rate of RCB0/1 after neoadjuvant treatment, according to the MD Anderson Cancer Center procedures, as per local assessment., Rate of ROR-low (at surgery) after neoadjuvant treatment, according to Prosigna test., Estimation of DMFS in ROR-med/high group., Incidence, duration and severity of Adverse Events (AEs) assessed by the NCI Common Terminology for Classification of Adverse Events (CTCAE) version 4.03, including dose reductions, delays and treatment discontinuations.

Source: https://euclinicaltrials.eu/ctis-public/view/2023-508827-10-00